EU clinical trial 2024-516550-21-00: A pilot study to assess the influence of drug transporters on brain and organ distribution of erlotinib in humans
Sponsor: Medical University Of Vienna (Educational Institution). Phase: Human Pharmacology (Phase I)- First administration to humans. Countries: Austria (ongoing, recruiting).
Therapeutic area(s): Not possible to specify
Gender: Female, Male. Age: 18-64 years, 65+ years. Enrolment: 87.
Status: Ongoing, recruiting. Start date (EU): 2015-06-26. Decision date: 2024-12-11. Results received: No. Last updated: 2024-12-11.

Condition(s): cancer

Source: https://euclinicaltrials.eu/ctis-public/view/2024-516550-21-00